EU clinical trial 2024-512456-38-00: A phase II randomized trial, non comparative, evaluating chemotherapy associated cisplatin, 5-fluorouracil and docetaxel at adapted doses in patients with locally advanced squamous cell carcinoma
Sponsor: Groupe Oncologie Radiotherapie Tete Cou (Patient organisation/association). Phase: Therapeutic exploratory (Phase II). Countries: France (ended).
Therapeutic area(s): Diseases [C] - Hemic and Lymphatic Diseases [C15]
Gender: Female, Male. Age: 18-64 years, 65+ years. Enrolment: 105.
Status: Ended. Start date (EU): 2021-02-04. End date (EU): 2025-08-05. Decision date: 2024-04-17. Results received: No. Last updated: 2025-03-03.

Condition(s): locally advanced squamous cell carcinoma
Product: DOCETAXEL HOSPIRA 10 mg/mL, solution à diluer pour perfusion, Fluorouracil Accord 50 mg/ml Injektions-/ Infusionslösung, Fluorouracil Accord 50 mg/ml διάλυμα για ένεση/έγχυση, Cisplatin Accord 1 mg/ml Konzentrat zur Herstellung einer Infusionslösung, DOCETAXEL HOSPIRA 10 mg/mL, solution à diluer pour perfusion, Cisplatine Hospira 100 mg/100 ml Onco-Tain solution injectable

Primary endpoint: Rate of patient success at 8 weeks
Endpoint(s): Overall survival defined by the time between the date of randomization and the date of death from any cause. In the absence of notification of death, survival data will be censored on the date of last news without progression., Progression-free survival defined by the time between the date of randomization and the date of first evidence of progression, the date of death from any cause or the date of last news without progression., Rate of patients in local and/or locoregional control of the disease at week 8 ± 3 days., Rate of patients with larynx preservation. Is considered as total laryngectomy event., Metastasis-free survival defined by the time between the date of randomization and the date of first evidence of metastatic progression, or the date of death, whatever the cause., Toxicity of complementary treatment to induction treatment., Rate of patients who received the entire induction treatment., Rate of patients who received the entire complementary treatment to induction treatment., Hospitalization or extension of hospitalization for toxicity linked to the treatments under study., Quality of life according to the EORTC QLQ-C30 and EORTCH& N35 questionnaires

Source: https://euclinicaltrials.eu/ctis-public/view/2024-512456-38-00